EU clinical trial 2025-521876-77-00: A PHASE 1 TRIAL TO EVALUATE THE SAFETY, TOLERABILITY, PK, AND PD of AX-0810 IN HEALTHY PARTICIPANTS
Protocol code: PQ-0810-001
Sponsor: ProQR Therapeutics VIII B.V. (Pharmaceutical company). Phase: Human Pharmacology (Phase I)- First administration to humans. Countries: Netherlands (ongoing, recruiting).
Therapeutic area(s): Diseases [C] - Nutritional and Metabolic Diseases [C18]
Gender: Female, Male. Age: 18-64 years. Enrolment: 37.
Status: Ongoing, recruiting. Start date (EU): 2025-11-03. Decision date: 2025-10-14. Results received: No. Last updated: 2026-03-16.
Decision dates by country: NL: 2025-10-15

Condition(s): Cholestatic liver disease

Source: https://euclinicaltrials.eu/ctis-public/view/2025-521876-77-00